EU clinical trial 2024-510810-33-00: An Open-Label Long-Term Phase III Extension Study to Assess the Long-Term Safety and Tolerability of Dexpramipexole in Participants with Severe Eosinophilic Asthma (EXHALE-5)
Protocol code: AR-DEX-22-04
Sponsor: Areteia Therapeutics Inc. (Pharmaceutical company). Phase: Therapeutic confirmatory (Phase III). Countries: Poland (ended), Romania (ended), Bulgaria (ended), Czechia (ended), Germany (ended), Italy (ended), Spain (ended).
Therapeutic area(s): Diseases [C] - Respiratory Tract Diseases [C08]
Gender: Female, Male. Age: 0-17 years, 18-64 years, 65+ years. Enrolment: 48.
Start date (EU): 2024-10-14. Decision date: 2024-09-22. Results received: No. Last updated: 2025-11-03.
Decision dates by country: PL: 2024-09-22, RO: 2024-09-23, BG: 2024-09-24, IT: 2025-11-03, ES: 2025-10-06, CZ: 2025-01-29, DE: 2025-01-14

Condition(s): Severe eosinophilic asthma
Product: Dexpramipexole (KNS-760704)

Primary endpoint: Assessment of treatment emergent AEs (TEAEs), clinical laboratory parameters, vital signs, and 12-lead ECGs.
Endpoint(s): Annualized rate of severe asthma exacerbations over 52 weeks., Asthma Control Questionnaire-6 (ACQ-6), change from baseline, at Weeks 16, 32, and 52., Absolute eosinophil counts (AEC), change from baseline, at Weeks 16, 32, and 52.

Source: https://euclinicaltrials.eu/ctis-public/view/2024-510810-33-00